EU clinical trial 2024-511235-10-00: TRIANGLE - autologous Transplantation after a Rituximab/Ibrutinib/Ara-c containing iNduction in Generalized mantle cell Lymphoma – a randomized European mcl network trial
Protocol code: TRIANGLE
Sponsor: Klinikum der Universitaet Muenchen AöR (Hospital/Clinic/Other health care facility). Phase: Therapeutic confirmatory (Phase III). Countries: Norway (ended), Spain (ended), Poland (ended), Czechia (ended), Sweden (ended), Belgium (ended), Italy (ended), Portugal (ended), Finland (ended), Denmark (ended), Germany (ended), Netherlands (ended).
Therapeutic area(s): Diseases [C] - Neoplasms [C04]
Gender: Female, Male. Age: 18-64 years. Enrolment: 832.
Status: Ended. Start date (EU): 2016-07-25. End date (EU): 2025-12-22. End date: 2025-12-23. Decision date: 2024-11-08. Results received: No. Last updated: 2025-06-13.
Decision dates by country: BE: 2024-11-12, CZ: 2024-11-12, DK: 2024-11-11, FI: 2024-11-11, PT: 2024-11-08, ES: 2024-11-12, SE: 2024-11-11, NO: 2024-11-11, PL: 2024-11-24, NL: 2024-11-11, IT: 2024-11-18, DE: 2024-11-12

Condition(s): Generalized mantle cell Lymphoma
Product: IBRUTINIB

Primary endpoint: FFS defined as time from randomization to stable disease at end of immuno-chemotherapy, progressive disease, or death from any cause.
Endpoint(s): Overall survival (OS), Progression-free survival (PFS) from randomization, from end of induction immuno-chemotherapy in patients with CR or PR at end of induction immuno-chemotherapy, and from the staging 6 weeks after end of induction assessment (at month 6), Overall response and complete remission rates at midterm, at end of induction, 3 months after end of induction immunochemotherapy (at month 6), PR to CR conversion rate during follow-up after end of induction immuno-chemotherapy, Rates of AEs, SAEs, and SUSARs by CTC grade (Version 4.03) during induction immuno-chemotherapy and during periods of follow-up after response to immune-chemotherapy, Cumulative incidence rates of SPMs

Source: https://euclinicaltrials.eu/ctis-public/view/2024-511235-10-00